EU clinical trial 2025-521385-10-00: ENDO-67 project: Investigating ENDOcrine therapy-related questions using Ki67 changes in the window-of-opportunity before breast surgery
Sponsor: Erasmus Universitair Medisch Centrum Rotterdam (Erasmus MC) (Hospital/Clinic/Other health care facility). Phase: Therapeutic use (Phase IV). Countries: Netherlands (authorised, recruitment pending).
Therapeutic area(s): Diseases [C] - Neoplasms [C04]
Gender: Female, Male. Age: 18-64 years, 65+ years. Enrolment: 175.
Status: Authorised, recruitment pending. Decision date: 2025-10-21. Results received: No. Last updated: 2025-10-21.

Condition(s): Breast cancer
Product: TAMOXIFEN

Primary endpoint: Endoxifen levels after three months of continuous use of 20mg (standard dose) of tamoxifen, Tamoxifen resistance defined as Ki67 >10% after three weeks of tamoxifen use according to an adequate dosing schedule, Intratumoral endoxifen levels after three weeks and Ki67 response defined as difference between Ki67 percentage for and Ki67 percentage after three weeks of tamoxifen according to an adequate dosing schedule
Endpoint(s): Ki67 percentages on tumor material, Levels on estradiol and progesterone in blood after three weeks and three months of tamoxifen treatment, Ki67 percentages on tumor material measured by the pathologist and measured by an AI algorithm, Change in scores of the FACT-ES questionnaire

Source: https://euclinicaltrials.eu/ctis-public/view/2025-521385-10-00